EU clinical trial 2022-501943-34-00: A Randomized, Double-blind, Placebo-Controlled, Phase 3 Study to Evaluate the Efficacy and Safety of Fazirsiran in the Treatment of Alpha-1 Antitrypsin Deficiency–Associated Liver Disease With METAVIR Stage F2 to F4 Fibrosis
Protocol code: TAK-999-3001
Sponsor: Takeda Development Center Americas Inc. (Pharmaceutical company). Phase: Therapeutic confirmatory (Phase III). Countries: Belgium (ongoing, recruiting), Austria (ongoing, recruiting), Poland (ongoing, recruiting), Ireland (authorised, recruiting), Germany (ongoing, recruiting), Italy (ongoing, recruiting), France (ongoing, recruiting), Spain (ongoing, recruiting), Portugal (ongoing, recruiting), Czechia (ongoing, recruiting), Sweden (ongoing, recruiting), Netherlands (ongoing, recruiting), Denmark (ongoing, recruiting).
Therapeutic area(s): Diseases [C] - Nutritional and Metabolic Diseases [C18]; Not possible to specify
Gender: Female, Male. Age: 18-64 years, 65+ years. Enrolment: 94.
Start date (EU): 2023-06-27. Decision date: 2023-05-09. Results received: No. Last updated: 2026-08-07.
Decision dates by country: FR: 2023-05-09, ES: 2023-05-10, SE: 2024-05-24, BE: 2023-05-15, AT: 2023-05-15, PL: 2023-05-15, IE: 2023-05-12, CZ: 2024-06-10, PT: 2023-05-11, DK: 2025-05-28, IT: 2023-05-09, NL: 2024-06-07, DE: 2023-05-10

Condition(s): Alpha-1 Antitrypsin Deficiency-Associated Liver Disease
Product: Fazirsiran, SALINE

Primary endpoint: The primary endpoint of this study is decrease from baseline of at least stage of histologic fibrosis (Meta-Analysis of Histological Data in Viral Hepatitis [METAVIR] staging) in the centrally read liver biopsy done at Week 106 in AATD-LD with METAVIR stage F2 and F3 fibrosis (Yes/No).
Endpoint(s): 1. Percent change from baseline in intrahepatic Z-AAT protein at Week 106 in AATD-LD with METAVIR stage F2 to F3 fibrosis., 2. Decrease from baseline of at least 1 stage of histologic fibrosis (METAVIR staging) in the centrally read liver biopsy done at Week 202 in AATD-LD with METAVIR stage F2 to F4 fibrosis (Yes/No), 3. Disease progression, which is defined as progression to cirrhosis or any of the qualifying liver-related clinical events by Week 202 in AATD-LD with METAVIR stage F2 to F4 fibrosis, including the occurrence of 1 or more of the following aggregated liver related clinical events during this period (Yes/No), 4. Change from baseline in serum Z-AAT protein at Week 202 in AATD-LD with METAVIR stage F2 to F4 fibrosi, 5. Change from baseline in intrahepatic Z-AAT protein polymer burden assessed by periodic acid Schiff plus diastase (PAS+D) staining in Week 202 liver biopsy in AATD-LD with METAVIR stage F2 to F4 fibros, 6. Change from baseline in intrahepatic portal inflammation in Week 202 liver biopsy in AATD-LD with METAVIR stage F2 to F4 fibrosis., 7. Change from baseline in vibration-controlled transient elastography (VCTE)-derived liver stiffness at Week 202 in AATD-LD with METAVIR stage F2 to F4 fibrosis., The secondary PK endpoints are: 1. Observed plasma concentrations of fazirsiran on Day 1 (predose, 2, 4, and 6 hours postdose), and predose and 2 hours postdose at Weeks 4, 16, 28, 40, 52, 76, 100, 124, 148, 172 and 196 and anytime at Weeks 106, 202, and safety follow-up.

Source: https://euclinicaltrials.eu/ctis-public/view/2022-501943-34-00